EU clinical trial 2024-515564-32-00: A PHASE 2, DOUBLE-BLIND, REPEAT-DOSE, PLACEBO-CONTROLLED CROSSOVER STUDY TO EVALUATE THE SAFETY, TOLERABILITY, PHARMACOKINETICS, AND PHARMACODYNAMICS OF CRD-4730 IN PARTICIPANTS WITH CATECHOLAMINERGIC POLYMORPHIC VENTRICULAR TACHYCARDIA
Protocol code: CRD-4730-202
Sponsor: Cardurion Pharmaceuticals Inc. (Pharmaceutical company). Phase: Therapeutic exploratory (Phase II). Countries: Netherlands (ongoing, recruiting), Spain (ongoing, recruiting), France (ongoing, recruiting), Italy (ongoing, recruiting).
Therapeutic area(s): Diseases [C] - Cardiovascular Diseases [C14]; Diseases [C] - Congenital, Hereditary, and Neonatal Diseases and Abnormalities [C16]
Gender: Female, Male. Age: 18-64 years, 65+ years. Enrolment: 6.
Status: Ongoing, recruiting. Start date (EU): 2025-11-20. Decision date: 2025-04-01. Results received: No. Last updated: 2026-06-30.
Decision dates by country: IT: 2025-04-03, ES: 2025-04-01, FR: 2025-04-01, NL: 2025-04-01

Condition(s): Catecholaminergic Polymorphic Ventricular Tachycardia
Product: CRD-4730 matching placebo, CRD-4730

Primary endpoint: The number and severity of treatment-emergent adverse events (TEAEs) related to study drug treatment
Endpoint(s): Change in VA score during EST from baseline to Day {CCI}, from baseline to Day {CCI}, and from baseline to Day {CCI}, Plasma concentrations of CRD-4730 over time for each treatment period

Source: https://euclinicaltrials.eu/ctis-public/view/2024-515564-32-00